EU clinical trial 2023-509538-20-01: MAESTRO-4MS : "Allogenic Adipose tissue-derived Mesenchymal Stromal Cells for the treatment of Primary Progressive Multiple Sclerosis: an open-label phase I clinical trial."
Protocol code: 35RC21_9806
Sponsor: Centre Hospitalier Universitaire De Rennes (Hospital/Clinic/Other health care facility). Phase: Human Pharmacology (Phase I)- First administration to humans. Countries: France (ongoing, recruiting).
Therapeutic area(s): Diseases [C] - Nervous System Diseases [C10]
Gender: Female, Male. Age: 18-64 years. Enrolment: 15.
Status: Ongoing, recruiting. Start date (EU): 2025-03-06. Decision date: 2024-07-04. Results received: No. Last updated: 2026-07-02.

Condition(s): Primary Progressive Multiple Sclerosis

Source: https://euclinicaltrials.eu/ctis-public/view/2023-509538-20-01